EU clinical trial 2022-502270-17-00: Long-term efficacy and tolerability of add-on pramipexole for anhedonic depression – an open label follow-up study
Sponsor: Region Skane (Hospital/Clinic/Other health care facility). Phase: Therapeutic confirmatory (Phase III). Countries: Sweden (ended).
Therapeutic area(s): Psychiatry and Psychology [F] - Mental Disorders [F03]
Gender: Female, Male. Age: 18-64 years, 65+ years. Enrolment: 80.
Status: Ended. Start date (EU): 2023-04-21. End date (EU): 2026-03-11. Decision date: 2023-02-09. Results received: No. Last updated: 2025-04-22.

Condition(s): Depression
Product: PRAMIPEXOLE, PRAMIPEXOLE, PRAMIPEXOLE, PRAMIPEXOLE

Primary endpoint: Total SHAPS-C scores
Endpoint(s): HDRS6 scores, Number of steps/day, movement pattern distribution over the day, walking distance, time spent in light, moderate and intense physical activity, resting heart rate, blood oxygen saturation, heart rate variability (stress scores), sleep latency (time to fall asleep), sleep awakening (how often you wake up during the night), wakefulness (time in minutes awake during a night), time in deep sleep, sleep efficiency (time asleep vs. total time in bed)., Total scores of DARS, MADRS-S, Insomnia Severity Scale, AES, GAD-7 and BBQ., Adverse events and side effects, fMRI, blood and CSF biomarkers from the RCT as treatment predictors., Neuropsychological test battery consisting of WAIS-IV, RBANS, D-KEFS, CPT-3 and cognitive self-assessment PDQ-5.

Source: https://euclinicaltrials.eu/ctis-public/view/2022-502270-17-00